EU clinical trial 2023-505714-19-00: Evaluation of the safety of a strategy combining etanercept administration with repeated contrast ultrasound in patients with Alzheimer's disease: a phase I study
Sponsor: Hopital Fondation Adolphe De Rothschild (Hospital/Clinic/Other health care facility). Phase: Human Pharmacology (Phase I)- Other. Countries: France (ongoing, recruiting).
Therapeutic area(s): Diseases [C] - Nervous System Diseases [C10]
Gender: Female, Male. Age: 18-64 years, 65+ years. Enrolment: 5.
Status: Ongoing, recruiting. Start date (EU): 2025-04-16. Decision date: 2024-07-01. Results received: No. Last updated: 2026-05-21.

Condition(s): Alzheimer's disease

Source: https://euclinicaltrials.eu/ctis-public/view/2023-505714-19-00